EU clinical trial 2022-501788-41-00: A Phase 3 Multicenter Study to Evaluate Efficacy, Safety, and Pharmacokinetics of Upadacitinib with Open-Label Induction, Randomized, Double-Blind Maintenance and Open-Label Long-Term Extension in Pediatric Subjects with Moderately to Severely Active Ulcerative Colitis and Inadequate Response, Intolerance, or Medical Contraindications to Corticosteroids, Immunosuppressants, and/or Biologic Therapy
Protocol code: M14-658
Sponsor: Abbvie Deutschland GmbH & Co. KG (Pharmaceutical company). Phase: Therapeutic confirmatory (Phase III). Countries: Greece (ongoing, recruitment ended), Bulgaria (ongoing, recruitment ended), Spain (ongoing, recruitment ended), Italy (ongoing, recruitment ended), Netherlands (ended), Poland (ongoing, recruitment ended), Germany (ongoing, recruitment ended), Belgium (ongoing, recruitment ended), Hungary (ended), France (ongoing, recruitment ended), Czechia (ended).
Therapeutic area(s): Diseases [C] - Digestive System Diseases [C06]
Gender: Female, Male. Age: 0-17 years. Enrolment: 46.
Start date (EU): 2023-11-14. Decision date: 2023-10-23. Results received: No. Last updated: 2026-08-05.
Decision dates by country: HU: 2023-10-25, NL: 2023-10-24, GR: 2023-10-24, DE: 2023-10-24, ES: 2023-10-23, FR: 2023-10-27, BG: 2023-10-30, IT: 2023-10-25, BE: 2023-10-24, PL: 2023-10-30, CZ: 2024-11-28

Condition(s): Ulcerative Colitis
Product: Upadacitinib, Upadacitinib, Upadacitinib, Upadacitinib, Upadacitinib

Primary endpoint: Induction: AMS clinical remission at Week 8., Maintenance: AMS clinical remission at Week 52 among Week 8 responders per AMS.
Endpoint(s): Achievement of endoscopic improvement (defined as Mayo Endoscopic Score [MES] ≤ 1) at Week 8., Achievement of Partial Mayo Score (PMS) clinical remission (defined as a PMS ≤ 2 and no individual subscore > 1) at Week 8., Achievement of AMS clinical response (defined as decrease in AMS by ≥ 2 points and ≥ 30% from Baseline with a decrease in Rectal Bleeding Subscore [RBS] of ≥ 1 or an absolute RBS of 0 or 1) at Week 8., Achievement of endoscopic improvement at Week 52 among Week 8 responders per AMS., Achievement of PMS clinical remission at Week 52 among Week 8 responders per AMS., Achievement of AMS clinical response at Week 52 among Week 8 responders per AMS., Achievement of PMS clinical response (defined as decrease in PMS by ≥ 2 points and ≥ 30% from Baseline with a decrease in RBS ≥ 1 or an absolute RBS of 0 or 1) at Week 52 among Week 8 clinical responders per AMS., Ability to discontinue corticosteroids prior to Week 52 and achievement of AMS clinical remission (achievement of CS-free AMS clinical remission) at Week 52 among Week 8 responders per AMS., Achievement of AMS clinical remission at Week 52 among Week 8 remitters per AMS.

Source: https://euclinicaltrials.eu/ctis-public/view/2022-501788-41-00